EU clinical trial 2025-522792-29-00: An Open-label, Multicenter, Randomized, Non-Inferiority Pharmacokinetic and Safety/Tolerability Study of Two Different Weekly Doses of Alpha1-Proteinase Inhibitor Subcutaneous (Human) 15% in Patients with Alpha1-Antitrypsin Deficiency Compared to Corresponding Standard 60 mg/kg/week and 120 mg/kg/week Doses of Intravenous Alpha1-Proteinase Inhibitor (5%)
Protocol code: GC2501
Sponsor: Grifols Therapeutics LLC (Pharmaceutical company). Phase: Therapeutic confirmatory (Phase III). Countries: Poland (authorised, recruitment pending), Denmark (authorised, recruitment pending), Netherlands (authorised, recruitment pending), Ireland (authorised, recruitment pending), Sweden (authorised, recruitment pending), Spain (authorised, recruitment pending), Portugal (authorised, recruitment pending), Germany (authorised, recruitment pending), France (authorised, recruitment pending).
Therapeutic area(s): Diseases [C] - Respiratory Tract Diseases [C08]
Gender: Female, Male. Age: 18-64 years, 65+ years. Enrolment: 47.
Status: Authorised, recruitment pending. Decision date: 2026-01-27. Results received: No. Last updated: 2026-07-16.
Decision dates by country: NL: 2026-01-28, IE: 2026-01-30, PL: 2026-01-30, SE: 2026-01-28, ES: 2026-02-02, PT: 2026-01-28, DK: 2026-01-27, DE: 2026-06-11, FR: 2026-06-26

Condition(s): Alpha-1 Antitrypsin Deficiency
Product: Liquid Alpha1-Proteinase Inhibitor (Human) (Prolastin®-C Liquid or Liquid Alpha1-PI), Alpha1-Proteinase Inhibitor Subcutaneous (Human), 15% (Alpha-1 15%)

Primary endpoint: The primary PK endpoint is the steady-state AUC of alpha1-PI over the weekly dosing interval (from 0 to 7 days) (AUC0-7 days) in the IV ( commercially confidential information) and in the SC ( commercially confidential information) for both dose levels
Endpoint(s): The secondary PK endpoint is the steady-state mean trough alpha1-PI levels, following Liquid Alpha1-PI IV and Alpha-1 15% SC administration, determined as follows: • Liquid Alpha1-PI IV administration in ( commercially confidential information) : the average value of the steady-state trough alpha1-PI measurements obtained at ( commercially confidential information), Exploratory Pharmacokinetic Endpoints: ( commercially confidential information), Safety Endpoints: The following safety endpoints will be assessed in this study: • Adverse events (AEs), serious adverse events (SAEs), and AEs and SAEs leading to discontinuation • COPD exacerbations • Vital signs (heart rate [HR], blood pressure (BP), respiratory rate [RR], and temperature [T]) • Pulmonary function tests (PFTs)• Clinical laboratory parameters including: • Immunogenicity assessments, (Continuation of the first secondary endpoint) Alpha-1 15% SC administration in ( commercially confidential information) : the average value of the steady-state trough alpha1-PI measurements obtained at ( commercially confidential information) .

Source: https://euclinicaltrials.eu/ctis-public/view/2025-522792-29-00